EU clinical trial 2024-510671-38-00: A Single Dose, Two – stage, Fasting State, Bioequivalence Study of Rifaximin 200 mg, film-coated tablets (Antibiotice S.A.) vs. Normix® 200 mg, film-coated tablets (Alfasigma S.p.A)
Protocol code: RIFAAIS 01/2024
Sponsor: Antibiotice S.A. (Pharmaceutical company). Phase: Human Pharmacology (Phase I)- Bioequivalence Study. Countries: Romania (ended).
Therapeutic area(s): Diseases [C] - Digestive System Diseases [C06]; Diseases [C] - Bacterial Infections and Mycoses [C01]
Gender: Female, Male. Age: 18-64 years. Enrolment: 28.
Status: Ended. Start date (EU): 2024-05-26. End date (EU): 2024-06-17. Decision date: 2024-05-23. Results received: No. Last updated: 2024-05-23.

Condition(s): healthy subjects

Source: https://euclinicaltrials.eu/ctis-public/view/2024-510671-38-00